EU clinical trial 2024-517095-38-00: Imaging multiple myeloma patients in the REMNANT study with Fluciclovine PET/CT (FLUCIPET)
Protocol code: FLUCIPET
Sponsor: Oslo University Hospital HF (Hospital/Clinic/Other health care facility). Phase: Phase II and Phase III (Integrated). Countries: Norway (ongoing, recruiting).
Therapeutic area(s): Diseases [C] - Neoplasms [C04]; Analytical, Diagnostic and Therapeutic Techniques and Equipment [E] - Diagnosis [E01]
Gender: Female, Male. Age: 18-64 years. Enrolment: 50.
Status: Ongoing, recruiting. Start date (EU): 2023-12-18. Decision date: 2024-11-14. Results received: No. Last updated: 2025-05-27.

Condition(s): multiple myeloma
Product: Axumin 1,600 MBq/mL solution for injection

Primary endpoint: The number of patients with positive Fluciclovine PET/CT and negative FDG PET/CT and how this correlate to PFS and OS
Endpoint(s): The number of patients with positive Fluciclovine PET/CT and positive FDG PET/CT and how this correlate to PFS and OS, The number of patients with negative Fluciclovine PET/CT and positive FDG PET/CT and how this correlate to PFS and OS, The number of patients with negative Fluciclovine PET/CT and negative FDG PET/CT and how this correlate to PFS and OS, Evaluate the safety of Fluciclovine, by incidence and severity of AEs, Determine the agreement between Fluciclovine PET/CT and FDG PET/CT assessments

Source: https://euclinicaltrials.eu/ctis-public/view/2024-517095-38-00